EU clinical trial 2026-525449-57-00: Bioequivalence study 2 to compare pharmacokinetics of Parkinson´s disease drugs in healthy volunteers
Protocol code: 3135003
Sponsor: Orion Corporation (Pharmaceutical company). Phase: Human Pharmacology (Phase I)- Bioequivalence Study. Countries: Czechia (ended).
Therapeutic area(s): Diseases [C] - Nervous System Diseases [C10]
Gender: Female, Male. Age: 18-64 years. Enrolment: 40.
Status: Ended. Start date (EU): 2026-04-08. End date (EU): 2026-05-13. Decision date: 2026-03-27. Results received: No. Last updated: 2026-03-27.

Condition(s): Parkinson desease

Source: https://euclinicaltrials.eu/ctis-public/view/2026-525449-57-00